EU clinical trial 2025-523759-76-01: A Study to Learn How Different Amounts of the Study Medicine Called PF-08065010 are Tolerated and Act in the Body of Healthy Adults
Protocol code: C6341001
Sponsor: Pfizer Inc. (Pharmaceutical company). Phase: Human Pharmacology (Phase I)- First administration to humans. Countries: Belgium (ongoing, recruiting).
Therapeutic area(s): Diseases [C] - Immune System Diseases [C20]
Gender: Female, Male. Age: 18-64 years, 65+ years. Enrolment: 100.
Status: Ongoing, recruiting. Start date (EU): 2026-04-15. Decision date: 2026-03-17. Results received: No. Last updated: 2026-03-17.

Condition(s): Rheumatoid arthritis and Systemic Lupus Erythematosus

Source: https://euclinicaltrials.eu/ctis-public/view/2025-523759-76-01